EU clinical trial 2024-511957-23-00: A Randomized, Open-label, Phase 3 Study of Sacituzumab Govitecan Versus Treatment of Physician’s Choice in Participants With Endometrial Cancer Who Have Received Prior Platinum-Based Chemotherapy and Anti-PD-1/PD-L1 Immunotherapy
Protocol code: GS-US-682-6769
Sponsor: Gilead Sciences Inc. (Pharmaceutical company). Phase: Therapeutic confirmatory (Phase III). Countries: Italy (ongoing, recruitment ended), France (ongoing, recruitment ended), Poland (ongoing, recruitment ended), Germany (ongoing, recruitment ended), Greece (ongoing, recruitment ended), Czechia (ongoing, recruitment ended), Spain (ongoing, recruitment ended).
Therapeutic area(s): Diseases [C] - Neoplasms [C04]
Gender: Female. Age: 18-64 years, 65+ years. Enrolment: 179.
Status: Ongoing, recruitment ended. Start date (EU): 2025-01-03. Decision date: 2024-12-09. Results received: No. Last updated: 2026-01-29.
Decision dates by country: FR: 2024-12-09, CZ: 2024-12-10, PL: 2024-12-10, GR: 2024-12-09, IT: 2024-12-09, DE: 2024-12-09, ES: 2024-12-11

Condition(s): Recurrent or Persistent Endometrial Cancer
Product: PACLITAXEL, Trodelvy 200 mg powder for concentrate for solution for infusion, Doxorubicin Teva 2 mg/ml Concentrate for Solution for Infusion

Primary endpoint: PFS, defined as the time from the date of randomization until the date of objective progressive disease (PD), as assessed by BICR per RECIST v1.1, or death from any cause, whichever comes first, OS, defined as the time from the date of randomization until death due to any cause
Endpoint(s): ORR, defined as the percentage of participants who have achieved a CR or PR as best overall response that is confirmed ≥ 4 weeks after initial documentation of response as assessed by BICR per RECIST v1.1, Change from baseline in the physical functioning domain of the European Organisation for Research and Treatment of Cancer quality of life Questionnaire-Core 30 Version 3.0 (EORTC QLQ-C30) at Week 16, PFS, defined as the time from the date of randomization until the date ofobjective PD, as assessed by investigator per RECIST v1.1, or death from any cause, whichever comes first, ORR, defined as the percentage of participants who have achieved a CR or PR as best overall response that is confirmed ≥ 4 weeks after initial documentation of response as assessed by investigator per RECIST v1.1, DOR, defined as the time from the first documentation of CR or PR to the earlier of the first documentation of definitive PD as assessed by BICR and investigator per RECIST v1.1, or death from any cause, whichever comes first, CBR, defined as the percentage of participants with best overall response of CR or PR that is confirmed ≥ 4 weeks after initial documentation of response or durable stable disease (SD; duration of SD ≥ 6 months from randomization to disease progression), as assessed by BICR and investigator perRECIST v1.1, Incidence of treatment-emergent adverse events (TEAEs) and clinical laboratory abnormalities, Change from baseline in GHS/QoL domain of the EORTC QLQ-C30 at Week 16

Source: https://euclinicaltrials.eu/ctis-public/view/2024-511957-23-00